EU clinical trial 2023-507500-31-00: A Phase II/III Multicenter Study Evaluating the Efficacy and Safety of Multiple Targeted Therapies as Treatments for Patients with Advanced or Metastatic Non-Small Cell Lung Cancer (NSCLC) Harboring Actionable Somatic Mutations Detected in Blood (BFAST: Blood First Assay Screening Trial)
Protocol code: BO29554
Sponsor: F. Hoffmann-La Roche AG (Pharmaceutical company). Phase: Phase II and Phase III (Integrated). Countries: France (ended), Italy (ongoing, recruitment ended), Spain (ongoing, recruitment ended), Germany (ended), Belgium (ended), Poland (ongoing, recruitment ended).
Therapeutic area(s): Diseases [C] - Neoplasms [C04]
Gender: Female, Male. Age: 18-64 years, 65+ years. Enrolment: 272.
Start date (EU): 2017-08-22. Decision date: 2024-06-11. Results received: No. Last updated: 2026-08-03.
Decision dates by country: BE: 2024-06-17, DE: 2024-06-13, ES: 2024-06-11, PL: 2024-07-03, FR: 2024-06-12, IT: 2024-06-17

Condition(s): Advanced or metastatic Non-small cell lung cancer (NSCLC)

Primary endpoint: 1. Investigator-assessed ORR based on confirmed objective response (Cohorts A, B, D, and F), 2. Investigator-assessed PFS according to RECIST v1.1 (Cohort C) in bTMB the primary population of patients with a bTMB level equal to or greater than the higher validated cutoff (PP1), 3. Investigator-assessed 12-month time in response (TIR) per RECIST v1.1 (Cohort E), 4. Incidence, type, and severity of adverse events (based on the NCI CTCAE v5.0), (Cohorts G), 5. Change from baseline in targeted vital signs, clinical laboratory test results, ECG parameters (Cohorts G), 6. Tolerability of treatment as assessed through use of the NCI PRO-CTCAE (Cohort G) Frequency of patients' response of the degree they are troubled with treatment symptoms, as assessed through use of the single-item EORTC Item List (IL46) (Cohort G)
Endpoint(s): 1. Investigator-assessed DOR, CBR, and PFS per RECIST v1.1 (Cohorts A, B, and D), 2. IRF-assessed ORR, DOR, CBR, and PFS per RECIST v1.1 (Cohorts A, B, and D), 3. IRF-assessed PFS, ORR, and DOR according to RECIST v1.1 (Cohort C and F), 4. Investigator-assessed ORR, and DOR according to RECIST v1.1 (Cohort C), 5. Investigator- and IRF-assessed time to CNS progression according to RECIST v1.1 (Cohort D), 6. OS (Cohorts A, B, D, E, and F), 7. Investigator-assessed PFS rates at 6-month and 1-year landmark timepoints (Cohort C), 8. Incidence, type, and severity of adverse events (based on the NCI CTCAE v4.0)(Cohorts A-F), 9. Changes in vital signs, physical findings, and clinical laboratory results during and following administration of protocol-specified IMPs (Cohorts A, B, D, E, and F), 10. DLTs, if any, associated with alectinib at escalating doses in RET+ patients (Cohort B), 11. PK parameters of alectinib in RET+ patients (Cohort B), 12. Population PK analysis for entrectinib (Cohort D), 13. Time to confirmed deterioration (TTCD) in patient-reported lung cancer symptoms of cough, dyspnea, and chest pain, as measured by the symptoms in lung cancer (SILC) (Cohort A, B, D, E, F), 14. Proportion of patients who improved compared with baseline in patient-reported lung cancer symptoms of cough, dyspnea, and chest pain and TTD as measured by SILC (Cohorts A, B, C, D, E, and F), 15. Proportion of patients presenting with measurable CNS disease at baseline who improve compared with baseline in patient-reported cognitive function, fatigue, health-related quality of life (HRQoL), headache, and vision disorder per the corresponding scales of the EORTC QLQ-C30 and BN20 (Cohort D), 16. Mean change from baseline in HRQoL, patient functioning, and symptoms as measured by the EORTC QLQ-C30, QLQ-LC-13 or SILC (Cohorts A, B, C, D, E, and F), 17. Health status as assessed by the EQ-5D-5L questionnaire (Cohorts A, B, C, D, E, and F), 18. Relationship between circulating biomarkers related to alectinib exposure and efficacy (Cohorts A and B), to atezolizumab efficacy (Cohort C) to entrectinib efficacy (Cohort D), atezo + cobi + vem efficacy (Cohort E), and atezo + bev + carboplatin + pemetrexed efficacy (Cohort F), 19. OS in bTMB PP1 (Cohort C), 20. Investigator-assessed PFS according to RECIST v1.1 in bTMB the secondary population of all patients who are bTMB-positive, which is the intent-to-treat (ITT) population in this cohort (PP2) [Cohort C], 21. OS in bTMB PP2 (Cohort C), 22. Investigator and IRF-assessed ORR, DOR, and PFS per RECIST v1.1 (Cohort E), 23. Investigator-assessed DOR and PFS per RECIST v1.1 (Cohort F), 24. 9-month TIR (Cohort E), 25. 12-month TIR (Cohort E), 26. Serum concentration of atezo at specified timepoints (Cohort E and F), 27. Presence of ADAs against atezo during the study relative to the presence of ADAs at baseline (Cohort E and F), 28. Plasma concentrations of divarasib at specified timepoints

Source: https://euclinicaltrials.eu/ctis-public/view/2023-507500-31-00